EU clinical trial 2024-511112-24-00: A Phase 2, Parallel-Group, Dose-Range-Finding Study With Randomized Double-Blind Treatment and Open-Label Periods to Evaluate the Safety and Efficacy of ALKS 2680 in Subjects With Narcolepsy Type 1
Protocol code: ALKS 2680-201
Sponsor: Alkermes Inc. (Pharmaceutical company). Phase: Therapeutic exploratory (Phase II). Countries: Czechia (ended), Italy (ended), France (ended), Belgium (ended), Spain (ended), Netherlands (ended).
Therapeutic area(s): Diseases [C] - Nervous System Diseases [C10]
Gender: Female, Male. Age: 18-64 years, 65+ years. Enrolment: 117.
Status: Ended. Start date (EU): 2025-01-17. End date (EU): 2025-07-31. End date: 2025-07-31. Decision date: 2024-08-16. Results received: Yes. Last updated: 2025-07-08.
Decision dates by country: ES: 2024-08-20, CZ: 2024-08-20, IT: 2024-08-19, NL: 2024-08-16, FR: 2024-08-20, BE: 2024-08-19

Condition(s): Narcolepsy Type 1
Product: Placebo to match ALKS 2680, ALKS 2680, ALKS 2680, ALKS 2680

Primary endpoint: Change in the MSL on MWT from baseline to Week 6 by dose level
Endpoint(s): Change in ESS from baseline to Week 6 by dose level, Mean WCR as derived from the subject cataplexy diary over Weeks 5 and 6 by dose level, TEAEs by study period, Clinical laboratory assessments by study period, Vital signs by study period, Safety ECG by study period, C-SSRS by study period

Source: https://euclinicaltrials.eu/ctis-public/view/2024-511112-24-00